EU clinical trial 2024-515391-12-00: AKTive-001: A Phase 1/1b Multiple Cohort Trial of ALTA2618 in Patients with Advanced Solid Tumors with AKT1 E17K Mutation
Protocol code: 2618-001
Sponsor: Alterome Therapeutics Inc. (Pharmaceutical company). Phase: Human Pharmacology (Phase I)- First administration to humans. Countries: Spain (ended), France (ended).
Therapeutic area(s): Diseases [C] - Neoplasms [C04]
Gender: Female, Male. Age: 18-64 years, 65+ years. Enrolment: 20.
Status: Ended. Start date (EU): 2025-03-15. End date (EU): 2026-04-23. Decision date: 2025-02-17. Results received: No. Last updated: 2026-05-07.
Decision dates by country: ES: 2025-02-17, FR: 2025-04-08

Condition(s): Advanced Solid Tumors with AKT1 E17K Mutation

Source: https://euclinicaltrials.eu/ctis-public/view/2024-515391-12-00